EU clinical trial 2024-516629-30-00: Prospective, non randomized, Phase II study on MK-3475 in recurrent, platinum-resistant, CPS ≥1 positive ovarian, Fallopian tube and primary peritoneal cancer patients
Protocol code: MITO 27
Sponsor: Fondazione Policlinico Universitario Agostino Gemelli IRCCS (Hospital/Clinic/Other health care facility). Phase: Therapeutic exploratory (Phase II). Countries: Italy (ended).
Therapeutic area(s): Diseases [C] - Neoplasms [C04]
Gender: Female. Age: 18-64 years, 65+ years. Enrolment: 100.
Status: Ended. Start date (EU): 2021-06-24. End date (EU): 2026-04-30. Decision date: 2024-11-11. Results received: No. Last updated: 2024-11-11.

Condition(s): Recurrent, platinum-resistant, CPS >1 positive ovarian, Fallopian tube and primary peritoneal cancer patients
Product: KEYTRUDA 25 mg/mL concentrate for solution for infusion

Primary endpoint: Overall survival (OS)
Endpoint(s): Toxicity, Response rate, Progression free survival (PFS), Quality of Life

Source: https://euclinicaltrials.eu/ctis-public/view/2024-516629-30-00